EU clinical trial 2025-522410-23-00: Botulinum toxin in open abdomen closure. A multicentric randomized controlled single-blind clinical trial to evaluate the efficacy of early administration of botulinum toxin for primary midline closure in patients with an open abdomen.
Protocol code: Pilot BOTU-CLOSURE
Sponsor: Hospital Universitario La Paz (Hospital/Clinic/Other health care facility). Phase: Therapeutic use (Phase IV). Countries: Spain (authorised, recruitment pending).
Therapeutic area(s): Not possible to specify
Gender: Female, Male. Age: 18-64 years, 65+ years. Enrolment: 30.
Status: Authorised, recruitment pending. Decision date: 2026-03-04. Results received: No. Last updated: 2026-07-09.

Condition(s): open abdomen
Product: DYSPORT 500 U POLVO PARA SOLUCIÓN INYECTABLE, Suero fisiológico al 0,9%

Primary endpoint: Proportion (%) of patients achieving approximation of the middle fascial edges with sutures, regardless of adjunctive measures (e.g. traction sutures or temporary meshes), provided that definitive bridging with a permanent mesh is not used.
Endpoint(s): Incidence of treatment-emergent adverse events potentially related to botulinum toxin (e.g., clinically relevant muscle weakness, injection-site reactions), serious adverse events, and all-cause mortality through day 30., Time (in days) from the open-abdomen procedure to primary midline fascial closure or to planned ventral hernia is established (not total midline closure but skin closure)., Incidence of midline continuity defect (incisional hernia) confirmed by physical examination and/or imaging at 6 months., Mean number of patients achieving the primary objective with botulinum toxin administration within the first 24 hours compared to those administered between 24 and 48 hours., Incidence of respiratory complications (distress, atelectasis, prolonged intubation, reintubation within 72 hours or oxygen requirements) during acute hospitalization., SF-36 questionnaire results at 1 and 6-month follow-up., Incidence of surgical site infections based on the day of midline closure since the open abdomen, measured over 30 days without mesh and 90 days with mesh.

Source: https://euclinicaltrials.eu/ctis-public/view/2025-522410-23-00